EU clinical trial 2023-509331-83-00: A multicenter, randomized, double-blind, parallel group, placebo-controlled study to evaluate the efficacy and safety of iptacopan (LNP023) in complement 3glomerulopathy
Protocol code: CLNP023B12301
Sponsor: Novartis Pharma AG (Pharmaceutical company). Phase: Therapeutic confirmatory (Phase III). Countries: Germany (ongoing, recruitment ended), France (ended), Spain (ended), Slovakia (ended), Netherlands (ended), Greece (ended), Italy (ended).
Therapeutic area(s): Diseases [C] - Immune System Diseases [C20]
Gender: Female, Male. Age: 0-17 years, 18-64 years. Enrolment: 37.
Start date (EU): 2021-07-28. Decision date: 2024-07-08. Results received: No. Last updated: 2026-05-13.
Decision dates by country: SK: 2024-07-08, IT: 2024-07-29, GR: 2024-07-22, FR: 2024-07-11, NL: 2024-07-10, ES: 2024-07-11, DE: 2024-07-09

Condition(s): complement 3 glomerulopathy
Product: Placebo 0 mg hard gelatin capsule size 1, (placebo to lnp023 100 mg), Placebo 0 mg hard gelatin capsule size 0, (placebo to lnp023 200 mg), IPTACOPAN HYDROCHLORIDE, IPTACOPAN

Primary endpoint: Primary endpoint for adult participants: - Log-transformed ratio to baseline in UPCR (sampled from a 24-hour urine collection) Primary endpoint for adolescent participants: - Log-transformed ratio to baseline in UPCR (sampled from a 24-hour urine collection).
Endpoint(s): Secondary endpoint for adult participants: - Change from baseline in eGFR., Secondary endpoint for adult participants: - A participant meets the requirements of the composite renal endpoint if he/she satisfies: (1) a stable or improved eGFR compared to the baseline visit (≤15% reduction in eGFR), and (2) a ≥50% reduction in UPCR compared to the baseline visit., Secondary endpoint for adult participants: - Change from baseline in disease total activity score in a renal biopsy., Secondary endpoint for adult participants: - Change in the Functional Assessment of Chronic Illness Therapy-Fatigue (FACIT Fatigue) score., Secondary endpoint for adult participants: - Occurrence of clinically significant vital signs (msDBP, msSBP, heart rate), ECGs, and safety laboratory measurements, as well as adverse events (AEs), AEs of special interest, and study drug discontinuation due to an AE., Secondary endpoint for adolescent participants: - Change from baseline in eGFR., Secondary endpoint for adolescent participants: - A participant meets the requirements of the composite renal endpoint if he/she satisfies the following criteria at the 6-month time point: (1) a stable or improved eGFR compared to the baseline visit (≤15% reduction in eGFR), and (2) a ≥50% reduction in UPCR compared to the baseline visit., Secondary endpoint for adolescent participants: - Change from baseline to 6 months in the Functional Assessment of Chronic Illness Therapy-Fatigue (FACIT-Fatigue) score., Secondary endpoint for adolescent participants: - Occurrence of clinically significant vital signs, ECGs, and safety laboratory measurements, as well as adverse events (AEs), AEs of special interest, and study drug discontinuation due to an AE (or any safety issue) during the double-blind period of the study.

Source: https://euclinicaltrials.eu/ctis-public/view/2023-509331-83-00